EU clinical trial 2024-518451-39-00: A Phase 1/2 Randomized, Blinded, Dose-escalation Study to Evaluate the Safety and Efficacy of Intrathecal Administration of AAV9-ABCD1 Gene Therapy (SBT101) in Adult Patients with Adrenomyeloneuropathy
Protocol code: SBT101-CT101
Sponsor: Swanbio Therapeutics Limited (Pharmaceutical company). Phase: Human Pharmacology (Phase I)- First administration to humans. Countries: Netherlands (ended).
Therapeutic area(s): Diseases [C] - Nervous System Diseases [C10]
Gender: Male. Age: 18-64 years. Enrolment: 5.
Status: Ended. Start date (EU): 2023-09-19. End date (EU): 2025-07-14. End date: 2025-07-15. Decision date: 2024-11-19. Results received: Yes. Last updated: 2025-05-22.

Condition(s): Adrenomyeloneuropathy
Product: SBT101

Primary endpoint: Percentage of patients with at least 1 Grade III or Grade IV AE that is at least possibly related to SBT101 at Month 24, as reported by the patients or observed by the Investigator, after SBT101 treatment
Endpoint(s): • Changes in the 6-minute Walk Test (6MWT) at Month 12 and Month 24 compared to controls, and compared to the reference changes determined by the prospective SBTNHX-CT901 study., • Changes in the 2-minute Walk Test (2MWT) at Month 12 and Month 24 compared to controls, and compared to the reference changes determined by the prospective SBTNHX-CT901 study., • Changes in the 5 times Sit-to-Stand Test (5XSST) at Month 12 and Month 24 compared to controls, and compared to the reference changes determined by the prospective SBTNHX-CT901 study., • Changes in postural body sway amplitudes at Month 12 and Month 24 compared to controls, and compared to the reference changes determined by the prospective SBTNHX-CT901 study., • Proportions of patients with Expanded Disability Status Score (EDSS) of ≥5.5 at Month 12 and Month 24 compared to controls, and compared to the reference changes determined by the prospective SBTNHX-CT901 study., • Proportions of patients with increased anti-spasticity medication dose at Month 12 and Month 24 compared to controls, and compared to the reference changes determined by the prospective SBTNHX-CT901 study., • Changes in Timed Up and Go (TUG) at Month 12 and Month 24 compared to controls, and compared to the changes observed in the prospective SBTNHX-CT901 study., • Changes in Dual-task TUG (TUG-DT) at Month 12 and Month 24 compared to controls, and compared to the changes observed in the prospective SBTNHX-CT901 study., • Changes in Balance Evaluation System Test (miniBESTest) at Month 12 and Month 24 compared to controls, and compared to the changes observed in the prospective SBTNHX-CT901 study., • Changes in Clinical Global Impression (CGI; performed by a qualified professional) score at Month 12 and Month 24 compared to controls., • Changes in Patient Global Impression of Severity (PGI-S), Patient Global Impression of Severity – Balance (PGI-S Balance), and Patient Global Impression of Change – Balance (PGI-C Balance) scores at Month 12 and Month 24 compared to controls, and compared to the changes observed in the prospective SBTNHX-CT901 study., • Percentage of patients with at least 1 Grade III or Grade IV AE that is at least possibly related to SBT101 at Month 60, as reported by the patients or observed by the Investigator, after SBT101 treatment.

Source: https://euclinicaltrials.eu/ctis-public/view/2024-518451-39-00